EU clinical trial 2023-509717-36-00: Monotherapy with a P2Y12 inhibitor followed by a direct-acting oral anticoagulant in patients with ATRial fIbrillation undergoing suprafleX Cruz coronary stent implantation (MATRIX-2)
Protocol code: MATRIX-2
Sponsor: Insel Gruppe AG (Hospital/Clinic/Other health care facility). Phase: Therapeutic confirmatory (Phase III). Countries: Italy (ongoing, recruiting), Poland (ended), Germany (ongoing, recruiting), France (ongoing, recruiting), Spain (ongoing, recruiting), Belgium (ongoing, recruiting), Netherlands (ongoing, recruiting).
Therapeutic area(s): Diseases [C] - Cardiovascular Diseases [C14]
Gender: Female, Male. Age: 18-64 years, 65+ years. Enrolment: 1700.
Start date (EU): 2024-12-16. Decision date: 2024-08-13. Results received: No. Last updated: 2026-06-01.
Decision dates by country: BE: 2024-09-10, PL: 2024-09-22, NL: 2025-01-27, DE: 2024-09-09, FR: 2024-09-19, ES: 2024-09-17, IT: 2024-08-13

Condition(s): AF patients who have undergone successful PCI
Product: CLOPIDOGREL, DABIGATRAN, ACETYLSALICYLIC ACID, CLOPIDOGREL, APIXABAN, PRASUGREL, EDOXABAN, RIVAROXABAN, TICAGRELOR, TICAGRELOR, DABIGATRAN, APIXABAN, EDOXABAN, PRASUGREL, RIVAROXABAN

Primary endpoint: Major adverse cardiac or cerebral events (MACCE), defined as the composite of death from any cause, myocardial infarction, stroke, or non-CNS systemic embolism between randomization and up to 12 months, Major or clinically relevant non-major bleeding (MCB) defined according to the International Society of Thrombosis and Hemostasis (ISTH) criteria between randomization and up to 12 months
Endpoint(s): The individual components of each primary endpoints, The composite of death from cardiovascular causes, myocardial infarction, or stroke, The composite of death from cardiovascular causes, myocardial infarction, stroke or non-CNS systemic embolism, Death from cardiovascular or non-cardiovascular causes, The composite of stroke and non-CNS systemic embolism, Any stroke (including ischemic, hemorragic, and unknown types), Ischemic stroke, Hemorrhagic stroke, Transient ischemic attack, The composite of definite or probable stent thrombosis, Definite stent thrombosis, Hospitalization, The composite of death or hospitalization, Any target lesion revascularization, Any target vessel revascularization, Any revascularization, All bleeding events, also adjudicated according to BARC, TIMI or GUSTO scales, Transfusion rates both in patients with and/or without clinically detected overt bleeding

Source: https://euclinicaltrials.eu/ctis-public/view/2023-509717-36-00